EU clinical trial 2023-505177-32-00: A Phase 2, Randomized, Double-blind, Clinical Study of V940 (mRNA-4157) Plus Pembrolizumab (MK-3475) Versus Placebo Plus Pembrolizumab in the Adjuvant Treatment of Participants With Renal Cell Carcinoma (INTerpath-004)
Protocol code: V940-004
Sponsor: Merck Sharp & Dohme LLC (Pharmaceutical company). Phase: Therapeutic exploratory (Phase II). Countries: Spain (ongoing, recruitment ended), Poland (ongoing, recruitment ended), France (ongoing, recruitment ended), Germany (ongoing, recruitment ended), Italy (ongoing, recruitment ended).
Therapeutic area(s): Diseases [C] - Neoplasms [C04]
Gender: Female, Male. Age: 18-64 years, 65+ years. Enrolment: 101.
Status: Ongoing, recruitment ended. Start date (EU): 2024-07-31. Decision date: 2024-03-19. Results received: No. Last updated: 2026-05-10.
Decision dates by country: PL: 2024-03-25, FR: 2024-03-20, ES: 2024-03-19, DE: 2024-03-25, IT: 2024-03-21

Condition(s): Intermediate-high -risk RCC, high-risk RCC who have undergone nephrectomy, or M1 NED RCC who have undergone nephrectomy and metastasectomy.
Product: KEYTRUDA 25 mg/mL concentrate for solution for infusion, Saline solution NACl 0.9%, mRNA-4157

Primary endpoint: Disease-Free Survival (DFS)
Endpoint(s): Distant Metastasis-free Survival (DMFS), Overall Survival (OS), Number of Participants Who Experience an Adverse Event (AE), Number of Participants Who Discontinue Study Treatment Due to an AE

Source: https://euclinicaltrials.eu/ctis-public/view/2023-505177-32-00